EU clinical trial 2025-522076-85-00: A Multicentre, Parallel-group, Phase II, Randomised, Double-blind, 4 Arm Study to Evaluate Efficacy and Safety of AZD1163 in Participants with Moderately-to-Severely Active Rheumatoid Arthritis (LaunchPAD-RA)
Protocol code: D9640C00003
Sponsor: AstraZeneca AB (Pharmaceutical company). Phase: Therapeutic exploratory (Phase II). Countries: Hungary (authorised, recruitment pending), Spain (authorised, recruiting), Bulgaria (authorised, recruiting), Germany (authorised, recruiting), Poland (ongoing, recruiting).
Therapeutic area(s): Diseases [C] - Immune System Diseases [C20]
Gender: Female, Male. Age: 18-64 years, 65+ years. Enrolment: 97.
Start date (EU): 2026-07-17. Decision date: 2026-04-22. Results received: No. Last updated: 2026-07-30.
Decision dates by country: PL: 2026-04-22, ES: 2026-04-22, DE: 2026-04-23, BG: 2026-04-24, HU: 2026-04-22

Condition(s): Rheumatoid arthritis
Product: AZD1163 Placebo, AZD1163

Primary endpoint: Change From Baseline in Disease Activity Score-C-Reactive Protein (DAS28-CRP) at Week 12
Endpoint(s): Percentage of Participants Achieving American College of Rheumatology Response Criteria 20 (ACR20) at Week 12 - Percentage of Participants Achieving ACR50 at Week 12 - Change From Baseline in Clinical Disease Activity Index (CDAI) at Week 12 - Change From Baseline in Simplified Disease Activity Index (SDAI) at Week 12, AZD1163 concentrations in serum., ADA (incidence, prevalence, and titres)

Source: https://euclinicaltrials.eu/ctis-public/view/2025-522076-85-00